EU clinical trial 2024-519393-39-00: A Phase 2, Open-label, Basket Study Investigating the Safety and Efficacy of GTX-102 in Adult and Pediatric Subjects with Deletion- or Nondeletion-type Angelman Syndrome
Protocol code: GTX-102-CL210
Sponsor: Ultragenyx Pharmaceutical Inc. (Pharmaceutical company). Phase: Therapeutic exploratory (Phase II). Countries: Portugal (ongoing, recruiting), Italy (ongoing, recruiting), France (ongoing, recruiting).
Therapeutic area(s): Diseases [C] - Congenital, Hereditary, and Neonatal Diseases and Abnormalities [C16]; Diseases [C] - Nervous System Diseases [C10]
Gender: Female, Male. Age: 0-17 years, 18-64 years. Enrolment: 19.
Status: Ongoing, recruiting. Start date (EU): 2026-02-27. Decision date: 2025-12-11. Results received: No. Last updated: 2026-04-27.
Decision dates by country: PT: 2025-12-10, FR: 2026-04-16, IT: 2025-12-11

Condition(s): Angelman Syndrome
Product: GTX-102, GTX/UX Diluent and Flush Solution

Primary endpoint: All Subprotocols - Primary Safety Endpoint: TEAEs and SAEs, frequency, severity, and relationship to investigational product, procedure, and premedication throughout the study., Subprotocol GTX-102-CL210A - Primary Efficacy Endpoint: Bayley-4 Cognitive raw score without caregiver input, change from Baseline at Day 338., Subprotocol GTX-102-CL210B - Primary Efficacy Endpoint: MDRI Net response at Day 338, with the following domains - assessments: Cognition - Bayley-4 Cognitive raw score, Communication - Bayley-4 Receptive Communication raw score, Behavior - ABC-C Hyperactivity/Noncompliance, Sleep - ASA Sleep rating, Motor Function - ASA Gross Motor rating., Subprotocol GTX-102-CL210C - Primary Efficacy Endpoint: MDRI Net response at Day 338, with the following domains - assessments: Expressive Communication - Vineland-3 Expressive Communication raw score, Receptive Communication – Vineland-3 Receptive Communication raw score, Behavior - ABC-C Irritability subscale score, Motor Function - ASA Gross Motor rating., Subprotocol GTX-102-CL210D - Primary Efficacy Endpoint: MDRI Net response at TxD 338, with the following domains - assessments: Cognition - Bayley-4 Cognitive raw score, Communication - Bayley-4 Receptive Communication raw score, Behavior - ABC-C Hyperactivity/Noncompliance, Sleep - ASA Sleep rating, Motor Function - ASA Gross Motor rating.
Endpoint(s): Subprotocol GTX-102-CL210A - Change from Baseline at Day 338 in: Bayley-4 Receptive Communication raw score, Bayley-4 Gross Motor raw score, Subprotocol GTX-102-CL210B - Change from Baseline at Day 338 in: Bayley-4 Cognitive raw score, Bayley-4 Receptive Communication raw score, Vineland-3 Receptive Communication raw score, Vineland-3 Expressive Communication raw score, ABC-C Hyperactivity/Noncompliance subscale score, ASA Sleep rating, ASA Gross Motor rating, Bayley-4 Gross Motor raw score., Subprotocol GTX-102-CL210C - Change from Baseline at Day 338 in: Vineland-3 Receptive Communication raw score, Vineland-3 Expressive Communication raw score, ABC-C Irritability subscale score, ASA Gross Motor rating., Subprotocol GTX-102-CL210D - Change from Baseline (or pretreatment) at TxD 338: Bayley-4 Cognitive raw score, Bayley-4 Receptive Communication raw score, Vineland-3 Receptive Communication raw score, Vineland-3 Expressive Communication raw score, ABC-C Hyperactivity/Noncompliance subscale score, ASA Sleep rating, ASA Gross Motor rating, Bayley-4 Gross Motor raw score.

Source: https://euclinicaltrials.eu/ctis-public/view/2024-519393-39-00